EU clinical trial 2023-505109-17-00: TOCIACS : Efficacy and safety of Tocilizumab for acute chest syndrome treatment in paediatric and adult patients with sickle cell disease
Protocol code: APHP220797
Sponsor: Assistance Publique Hopitaux De Paris (Hospital/Clinic/Other health care facility). Phase: Therapeutic confirmatory (Phase III). Countries: France (ongoing, recruiting).
Therapeutic area(s): Diseases [C] - Respiratory Tract Diseases [C08]; Diseases [C] - Hemic and Lymphatic Diseases [C15]
Gender: Female, Male. Age: 0-17 years, 18-64 years, 65+ years. Enrolment: 130.
Status: Ongoing, recruiting. Start date (EU): 2025-08-27. Decision date: 2024-10-08. Results received: No. Last updated: 2026-03-13.

Condition(s): Sickle cell disease
Product: CHLORURE DE SODIUM 0,9 % B. BRAUN, solution injectable en ampoule, TOCILIZUMAB

Primary endpoint: Time to successful weaning from both supplemental oxygen and any respiratory support, defined as SpO2 ≥ 95% without oxygen during the next 24 hours, and spontaneous breathing without any respiratory support (non-invasive or invasive) during the next 48 hours.

Source: https://euclinicaltrials.eu/ctis-public/view/2023-505109-17-00